EU clinical trial 2023-509152-33-00: A Dutch National Study on behalf of the Center for Personalized Cancer Treatment (CPCT) to Facilitate Patient Access to Commercially Available, Targeted Anti-cancer Drugs to determine the Potential Efficacy in Treatment of Advanced Cancers with a Known Molecular Profile: The Drug Rediscovery Protocol (DRUP trial)
Protocol code: M15DRU
Sponsor: Het Nederlands Kanker Instituut-Antoni van Leeuwenhoek Ziekenhuis Stichting (Hospital/Clinic/Other health care facility). Phase: Therapeutic exploratory (Phase II). Countries: Netherlands (ongoing, recruiting).
Therapeutic area(s): Diseases [C] - Neoplasms [C04]
Gender: Female, Male. Age: 18-64 years, 65+ years. Enrolment: 3000.
Status: Ongoing, recruiting. Start date (EU): 2016-07-25. Decision date: 2024-03-26. Results received: No. Last updated: 2025-12-19.

Condition(s): Advanced solid tumor, Non-Hodgkin lymphoma, T-cell prolymphocytic leukemia, Multiple myeloma
Product: Zejula 100 mg film-coated tablets, Zelboraf 240 mg film-coated tablets, Inlyta 1 mg film-coated tablets, Verzenios 50 mg film-coated tablets, Lorviqua 100 mg film-coated tablets, Tarceva 100 mg film-coated tablets, Tasigna 200 mg hard capsules, Stivarga 40 mg film-coated tablets, Tafinlar 75 mg hard capsules, Zejula 100 mg hard capsules, Tibsovo 250 mg film-coated tablets, Herceptin 150 mg powder for concentrate for solution for infusion, TEPMETKO 225 mg film-coated tablets, YERVOY 5 mg/ml concentrate for solution for infusion, Piqray 50 mg and 200 mg film-coated tablets, Tasigna 150 mg hard capsules, Sutent 12.5 mg hard capsules, Lorviqua 25 mg film-coated tablets, Tecentriq 1 200 mg concentrate for solution for infusion, OPDIVO 10 mg/mL concentrate for solution for infusion., XALKORI 200 mg hard capsules, Vizimpro 15 mg film-coated tablets, Vizimpro 30 mg film-coated tablets, Rubraca 250 mg film-coated tablets, Lynparza 150 mg film-coated tablets, Tarceva 150 mg film-coated tablets, Perjeta 420 mg concentrate for solution for infusion, Retsevmo 40 mg hard capsules, Pemazyre 4.5 mg tablets, LENVIMA 10 mg hard capsules, JNJ-61186372, Vectibix 20 mg/ml concentrate for solution for infusion, Rubraca 200 mg film-coated tablets, YERVOY 5 mg/ml concentrate for solution for infusion, CABOMETYX 60 mg film-coated tablets, Talzenna 0.25 mg hard capsules, JNJ-42756493, Avastin 25 mg/ml concentrate for solution for infusion., Erivedge 150 mg hard capsules, IMFINZI 50 mg/mL concentrate for solution for infusion., Mekinist 0.5 mg film-coated tablets, Avastin 25 mg/ml concentrate for solution for infusion., Retsevmo 80 mg hard capsules, KEYTRUDA 25 mg/mL concentrate for solution for infusion, XALKORI 250 mg hard capsules, Rozlytrek 100 mg hard capsules, Piqray 150 mg film-coated tablets, Tarceva 25 mg film-coated tablets, CABOMETYX 20 mg film-coated tablets, Inlyta 5 mg film-coated tablets, Mekinist 2 mg film-coated tablets, Rubraca 300 mg film-coated tablets, Cotellic 20 mg film-coated tablets, JNJ-42756493, Lynparza 100 mg film-coated tablets, Rozlytrek 200 mg hard capsules, JNJ-42756493, Talzenna 1 mg hard capsules, Sutent 25 mg hard capsules, Alecensa 150 mg hard capsules, LENVIMA 4 mg hard capsules, Tafinlar 50 mg hard capsules, Vizimpro 45 mg film-coated tablets

Primary endpoint: Percentage of patients that are treated based on their molecular tumor profile, Objective tumor response, Disease control, defined as Stable Disease (SD) at 16 weeks after treatment initiation, Treatment-related grade≥3 and serious adverse events
Endpoint(s): Progression-free and overall survival, Duration of treatment on study (time on drug)

Source: https://euclinicaltrials.eu/ctis-public/view/2023-509152-33-00